EU clinical trial 2022-502307-30-00: BACLOFEN FOR IMPROVING BENZODIAZEPINE TITRATION IN BENZODIAZEPINE DEPENDENCE. BABET
Protocol code: 69HCL21_1318
Sponsor: Hospices Civils De Lyon (Hospital/Clinic/Other health care facility). Phase: Phase II and Phase III (Integrated). Countries: France (ongoing, recruiting).
Therapeutic area(s): Psychiatry and Psychology [F] - Behavioral Disciplines and Activities [F04]
Gender: Female, Male. Age: 18-64 years. Enrolment: 93.
Status: Ongoing, recruiting. Start date (EU): 2026-01-15. Decision date: 2024-03-05. Results received: No. Last updated: 2026-04-15.

Condition(s): Psychiatrics disorders, addictology
Product: BACLOFEN, ZOLPIDEM, ZOPICLONE, Cellulose microcristalline

Primary endpoint: Difference in total benzodiazepine consumption, in mg-diazepam, between the 28 days before inclusion in the clinical trial and the last 28 days the last 28 days before visit 5 on Day 62/64 of randomisation
Endpoint(s): Frequency of serious and non-serious adverse events of special interest, and frequency of all-cause study discontinuations., Frequency of benzodiazepine discontinuation at the last visit of the treatment period (self-report and urine test); Benzodiazepine withdrawal severity score assessed by the Clinical Institute Withdrawal Assessment of Benzodiazepine (CIWA-B), Craving score assessed by the Visual Analog Scale (VAS), Anxiety symptoms assessed by the State Trait Inventory Anxiety (STAI-Y), Depression score assessed by the Montgomery-Åsberg Depression Rating Scale (MADRS), Subjective sleep quality assessed by the Pittsburgh Sleep Quality Index (PSQI), Quality of life (SF-12 v2).

Source: https://euclinicaltrials.eu/ctis-public/view/2022-502307-30-00